EU clinical trial 2025-523156-31-00: A phase 2b, multicenter, randomized, double-blind, placebo-controlled, parallel-group study to evaluate the safety, tolerability, and efficacy of S-337395 in symptomatic nonhospitalized adults with respiratory syncytial virus who are at high risk of progression to severe disease
Protocol code: 2402T1432
Sponsor: Shionogi B.V. (Pharmaceutical company). Phase: Therapeutic exploratory (Phase II). Countries: Bulgaria (ongoing, recruiting), Poland (authorised, recruitment pending).
Therapeutic area(s): Diseases [C] - Virus Diseases [C02]
Gender: Female, Male. Age: 18-64 years, 65+ years. Enrolment: 40.
Start date (EU): 2026-03-17. Decision date: 2025-11-18. Results received: No. Last updated: 2026-07-31.
Decision dates by country: BG: 2025-11-18, PL: 2026-03-13

Condition(s): Respiratory Syncytial Virus

Primary endpoint: Change from baseline in RSV RNA load by qRT-PCR (nasopharyngeal swab) on visit 2 (day 2), visit 3 (day 4), and visit 4 (day 6)
Endpoint(s): Assessment of TEAEs, clinical laboratory test results, 12-lead ECGs, physical examination findings, and vital signs measurements, Change from baseline over time in severity of RSV symptoms using RiiQ™: respiratory (RiiQ-RSS), systemic (RiiQ-SSS), and total (RiiQ-RSS + RiiQ-SSS). Time to resolution defined as return to baseline per PSQ. Includes time to first and sustained (2 days) resolution of respiratory, systemic, and combined symptoms, and resolution of each symptom separately, based on RiiQ subscales., Based on RSV virological assay (nasopharyngeal swabs): Change from baseline in RSV RNA load and infectious titer at each time point; AUC through day 6; time to first/sustained negative or , > Plasma concentrations of S-337395 after repeated oral doses of S-337395 > Plasma concentrations of S 337395 12 and 24 hours after the first dose and the last dose (C12 and C24)

Source: https://euclinicaltrials.eu/ctis-public/view/2025-523156-31-00